EU clinical trial 2023-506825-13-00: A randomised double-blind placebo-controlled clinical study investigating the effects of semaglutide s.c. once-weekly versus placebo on central and peripheral inflammation in participants with Alzheimer’s disease.
Protocol code: NN6535-7519
Sponsor: Novo Nordisk A/S (Pharmaceutical company). Phase: Therapeutic confirmatory (Phase III). Countries: Denmark (ended), Sweden (ended).
Therapeutic area(s): Diseases [C] - Nervous System Diseases [C10]
Gender: Female, Male. Age: 18-64 years, 65+ years. Enrolment: 13.
Status: Ended. Start date (EU): 2023-07-25. End date (EU): 2025-06-26. End date: 2025-09-08. Decision date: 2023-11-17. Results received: Yes. Last updated: 2025-02-17.
Decision dates by country: DK: 2023-11-17, SE: 2023-11-21

Condition(s): Mild cognitive impairment (MCI) or mild dementia, both of the Alzheimer’s type
Product: Ozempic 1 mg solution for injection in pre-filled pen, Semaglutide Placebo, Ozempic 0.5 mg solution for injection in pre-filled pen, Ozempic 0.25 mg solution for injection in pre-filled pen

Primary endpoint: Change in gene expression assessed by single-cell ribonucleic acid sequencing (scRNAseq) (cells in CSF) from baseline (week 0) to visit 5 (week 12), Change in gene expression assessed by scRNAseq (cells in blood) from baseline (week 0) to visit 5 (week 12)
Endpoint(s): Number of treatment emergent adverse events (TEAEs) from baseline (week 0) to visit 5 (week 12), Number of treatment emergent adverse events (TEAEs) from baseline (week 0) to end of treatment (week 64), Weekly average semaglutide concentration (C avg) based on population pharmacokinetics (PK) analysis from visit 3 (week 4) to end of treatment (week 64)

Source: https://euclinicaltrials.eu/ctis-public/view/2023-506825-13-00